EU clinical trial 2025-524899-40-00: A First-in-Human Clinical Trial to Assess the Safety, Tolerability and Pharmacokinetics of MR-L45 in Healthy Adults
Protocol code: MR-L45-101
Sponsor: Mironid Limited (Pharmaceutical company). Phase: Human Pharmacology (Phase I)- First administration to humans. Countries: Netherlands (ongoing, recruiting).
Therapeutic area(s): Diseases [C] - Congenital, Hereditary, and Neonatal Diseases and Abnormalities [C16]
Gender: Female, Male. Age: 18-64 years. Enrolment: 72.
Status: Ongoing, recruiting. Start date (EU): 2026-07-03. Decision date: 2026-04-01. Results received: No. Last updated: 2026-08-06.

Condition(s): Autosomal Dominant Polycystic Kidney Disease

Source: https://euclinicaltrials.eu/ctis-public/view/2025-524899-40-00